EU clinical trial 2025-520587-18-00: RENAISSANCE 2: A Double-Blind, Randomized, Placebo-Controlled, Multicenter, Parallel-Group Study to Evaluate the Efficacy, Safety, and Tolerability of SPN-817 in Adults with Focal Onset Seizures
Protocol code: 817P203
Sponsor: Supernus Pharmaceuticals Inc. (Pharmaceutical company). Phase: Therapeutic exploratory (Phase II). Countries: Poland (ongoing, recruiting), Hungary (authorised, recruitment pending), Bulgaria (authorised, recruiting).
Therapeutic area(s): Diseases [C] - Nervous System Diseases [C10]
Gender: Female, Male. Age: 18-64 years, 65+ years. Enrolment: 110.
Start date (EU): 2026-06-29. Decision date: 2025-10-20. Results received: No. Last updated: 2026-07-15.
Decision dates by country: PL: 2025-11-21, HU: 2025-10-20, BG: 2025-11-24

Condition(s): Focal Onset Seizures
Product: Huperzine A, Capsules, Huperzine A, Huperzine A

Primary endpoint: Percent change (PCH) from baseline in focal onset seizure frequency per 28 days over the Maintenance Period
Endpoint(s): 1. 50% responder rate over the Maintenance Period, 2. PCH from baseline in focal onset seizure frequency per 28 days over the entire Treatment Period (ie, Titration/Optimization + Maintenance Period), 3. 50% responder rate over the entire Treatment Period, 4A • Longest seizure-free interval over the entire Treatment Period • 30% and 75% responder rate over the entire Treatment Period and the Maintenance Period • Seizure-free rate over the Maintenance Period • Percentage of seizure-free days per 28 days over the Maintenance Period and the entire Treatment Period • Clinical Global Impression–Change (CGI-C) score at scheduled visits, 4B • Change from baseline (CFB) in Clinical Global Impression-Severity (CGI-S) score at scheduled visits • Patient Global Impression-Change (PGI-C) score at scheduled visits • CFB in Patient Global Impression-Severity (PGI-S) score at scheduled visits, 4C • CFB in the Quality of Life in Epilepsy (QOLIE31P; version 2.0) questionnaire score at scheduled visits • CFB in the Seizure Related Impact Assessment Scale (SERIAS) score at scheduled visits • Incidence of adverse events (AEs) over the entire study, 4D • CFB in clinical laboratory test results at scheduled visits • CFB in vital signs measurements at scheduled visits • CFB in 12-lead electrocardiogram (ECG) findings at scheduled visits, 4E • Columbia-Suicide Severity Rating Scale (C-SSRS) assessments at scheduled visits • Plasma concentrations of huperzine A • PK parameters by population PK analysis of huperzine A

Source: https://euclinicaltrials.eu/ctis-public/view/2025-520587-18-00